EU clinical trial 2023-504973-19-01: An international randomised trial of radical surgery followed by adjuvant therapy versus no further treatment in patients with early-stage, intermediate-risk cervical cancer (CERVANTES)
Sponsor: CEEGOG z.s. (Hospital/Clinic/Other health care facility). Phase: Therapeutic confirmatory (Phase III). Countries: Czechia (ongoing, recruiting), Italy (authorised, recruitment pending), Austria (authorised, recruitment pending), Belgium (authorised, recruitment pending), Spain (ongoing, recruiting), Poland (authorised, recruiting).
Therapeutic area(s): Diseases [C] - Neoplasms [C04]
Gender: Female. Age: 18-64 years, 65+ years. Enrolment: 273.
Start date (EU): 2023-09-06. Decision date: 2023-08-09. Results received: No. Last updated: 2026-06-27.
Decision dates by country: CZ: 2023-08-09, AT: 2026-01-30, IT: 2026-02-04, PL: 2026-01-30, BE: 2026-01-05, ES: 2026-01-29

Condition(s): early-stage, intermediate-risk cervical cancer
Product: Cisplatin Ebewe 1 mg/ml koncentrát pro infuzní roztok, Carboplatin Accord 10 mg/ml koncentrát pro přípravu infuzního roztoku, Carboplatin Kabi 10 mg/ml koncentrát pro infuzní roztok

Primary endpoint: Disease-free survival [ Time Frame: Analysed 3 years after randomization of the last patient. ]
Endpoint(s): 1. Overall survival. 2.Pelvic disease-free survival. 3. Health-related quality of life based questionnaire. 4. Treatment-related adverse events based on Common Terminology Criteria for Adverse Events v5.0.

Source: https://euclinicaltrials.eu/ctis-public/view/2023-504973-19-01